EU clinical trial 2024-517748-76-00: NEOadjuvant chemotherapy only compared with standard treatment for Locally Advanced Rectal cancer: a randomized phase II trial
Sponsor: Region Sjaelland (Hospital/Clinic/Other health care facility). Phase: Phase I and Phase II (Integrated)- Other. Countries: Denmark (ongoing, recruitment ended).
Therapeutic area(s): Diseases [C] - Neoplasms [C04]; Diseases [C] - Digestive System Diseases [C06]
Gender: Female, Male. Age: 18-64 years, 65+ years. Enrolment: 124.
Status: Ongoing, recruitment ended. Start date (EU): 2016-11-14. Decision date: 2024-10-08. Results received: No. Last updated: 2024-10-08.

Condition(s): Rectum cancer
Product: Capecitabine Pharmacare 150 mg film-coated tablets, Capecitabine Glenmark 500 mg filmomhulde tabletten, Capecitabine Accord 500 mg film-coated tablets, Oxaliplatin 5mg/ml concentrate for Solution for Infusion, Capecitabine Glenmark 150 mg film-coated tablets, 5-FU medac 50 mg/ml, Injektionslösung, Leucovorin 10 mg/ml Lösung zur Injektion/ Infusion

Primary endpoint: Disease free survival
Endpoint(s): • Overall survival • Local and distant relapse • Early and late toxicity • Functional outcome and QoL • Resection rate • Postoperative morbidity • Postoperative mortality • Rate of downsizing • Tumor regression grade • Translational research

Source: https://euclinicaltrials.eu/ctis-public/view/2024-517748-76-00